EU clinical trial 2023-505938-98-00: 68Ga-FAPI PET/CT: The Diagnostic Accuracy for Primary Staging and Re-staging of Patients with Ovarian Cancer
Sponsor: Aalborg University Hospital (Hospital/Clinic/Other health care facility). Phase: Therapeutic exploratory (Phase II). Countries: Denmark (ended).
Therapeutic area(s): Analytical, Diagnostic and Therapeutic Techniques and Equipment [E] - Diagnosis [E01]; Diseases [C] - Neoplasms [C04]
Gender: Female. Age: 18-64 years, 65+ years. Enrolment: 50.
Status: Ended. Start date (EU): 2023-11-17. End date (EU): 2026-05-08. Decision date: 2023-09-11. Results received: No. Last updated: 2026-03-03.

Condition(s): Ovarian Cancer
Product: 68Ga-FAPI-46, Fluor-18-FDG, 400 MBq-210 GBq, injektionsvreske Fludeoxyglucose (18F)

Primary endpoint: Compare the FAPI PET/CT and FDG PET/CT findings in primary tumor, regional lymph nodes and distant metastases to a histopathological reference standard where the sensitivity, specificity, positive predicative value, and negative predicative values of the PET/CTs are determined, both at primary staging and at restaging, Compare the cancer stage as determined by FAPI PET/CT compared to conventional imaging (including FDG PET/CT) at primary staging and at restaging (after neoadjuvant chemotherapy). The proportion of patients downstaged, unchanged stage, and upstaged, due to the added FAPI PET/CT are determined., Investigate what proportion of patients will be (hypothetically) treated differently due to an added FAPI PET/CT at primary staging and at restaging (after neoadjuvant chemotherapy) by the treating clinicians, Investigate the feasibility of FAPI PET/CT at restaging (after neoadjuvant chemotherapy) by comparing the FAPI PET/CT signal after neoadjuvant chemotherapy to a histopathological reference standard, Investigate the correlation between FAPI PET/CT SUV values and extent of FAP expressing CAFs in tumor deposits through volume-density estimation and immunohistochemical assessment of surgical specimens., Note reported discomfort, and measure heart rate and blood pressure before and at specific timepoints after FAPI infusion.
Endpoint(s): SUV and TBR values for primary, regional lymph nodes, and distant metastases for FAPI PET/CT and compare these values to FDG PET/CT, both at primary staging and at restaging (after neoadjuvant chemotherapy), Changes in SUV and TBR in primary, regional lymph nodes, and distant metastases for FAPI PET/CT - from before to after neoadjuvant chemotherapy and compare these values to the FDG PET/CT parameters., MTV and TLG for both FAPI PET/CT and FDG PET/CT at primary and restaging (after neoadjuvant chemotherapy) and compare these values between FAPI PET/CT and FDG PET/CT., Changes in MTV and TLG for both FAPI PET/CT and FDG PET/CT from before to after neoadjuvant chemotherapy and compare these values between FAPI PET/CT and FDG PET/CT., Seek supplementary information in medical records, biochemistry, pathology, or other imaging modalities for a final diagnosis/condition in cases of unexpected FAPI PET/CT findings not related to the known cancer, Correlate the FAPI PET/CT results/staging of patients to the actual clinical outcome and compare these to the FDG PET/CT results/staging. RFS and OS will be determined., Conduct an interobserver study of FAPI PET/CTs performed in the present and other future FAPI PET/CT in cancers studies.

Source: https://euclinicaltrials.eu/ctis-public/view/2023-505938-98-00